EU clinical trial 2024-516698-56-00: A Modular Phase I/II Open-label Dose Escalation and Dose Expansion Study to Evaluate the Safety, Pharmacokinetics, Pharmacodynamics, and Efficacy of AZD9793, a T cell-engaging Antibody Targeting Glypican-3 (GPC3) in Adult Participants with Advanced or Metastatic Solid Tumours (RHEA-1)
Protocol code: D7040C00001
Sponsor: AstraZeneca AB (Pharmaceutical company). Phase: Phase I and Phase II (Integrated)- First administration to humans. Countries: Spain (authorised, recruitment pending).
Therapeutic area(s): Diseases [C] - Neoplasms [C04]
Gender: Female, Male. Age: 18-64 years, 65+ years. Enrolment: 12.
Status: Authorised, recruitment pending. Decision date: 2026-03-03. Results received: No. Last updated: 2026-06-11.

Condition(s): Hepatocellular Carcinoma
Product: AZD9793

Primary endpoint: Incidence of DLTs (only for Dose Escalation)., Incidence of AEs, SAEs, and AESIs., Objective Response Rate (ORR) (For dose expansion only), AEs leading to discontinuation of AZD9793, Assess clinically significant alterations in vital signs and abnormal laboratory parameters
Endpoint(s): Objective Response Rate (ORR) (For dose escalation only), Best overall response (BOR), Disease Control Rate (DCR) at 12 weeks, Durable response rate (DRR), Duration of response (DoR), Time To Response (TTR), Change in target lesion (TL) tumour size, Progression free Survival (PFS), Overall Survival (OS) [Dose expansion only], Pharmacokinetics of AZD9793: Maximum serum concentration of the study drug (Cmax), serum concentrations of AZD9793, Area Under the concentration-time curve (AUC), Clearance, Terminal elimination half-life (t1/2), Number and percentage of participants who develop anti-drug antibodies (ADAs) measured in serum, CD8+ T cell infiltration in tumours pre- and post- treatment measured by immunohistochemistry

Source: https://euclinicaltrials.eu/ctis-public/view/2024-516698-56-00